EU clinical trial 2023-507658-34-00: Impact of dapagliflozin for the regulation of immunological activity in Membranous Nephropathy
Protocol code: 22-AOIP-06
Sponsor: Centre Hospitalier Universitaire De Nice (Hospital/Clinic/Other health care facility). Phase: Phase II and Phase III (Integrated). Countries: France (authorised, recruiting).
Therapeutic area(s): Diseases [C] - Immune System Diseases [C20]
Gender: Female, Male. Age: 18-64 years, 65+ years. Enrolment: 20.
Status: Authorised, recruiting. Start date (EU): 2025-09-19. Decision date: 2025-07-15. Results received: No. Last updated: 2025-07-15.

Condition(s): Membranous Nephropathy
Product: Forxiga 10 mg film-coated tablets

Primary endpoint: Change in anti-PLA2R1 antibody titer (ELISA titer in RU/mL) from baseline to 6 months after dapagliflozin treatment compared with pretreatment antibody titer
Endpoint(s): Change in proteinuria (in g/g) from baseline to 6 months after dapagliflozin treatment (under stable antiproteinuric treatment), Change in albumin levels (in g/L) from baseline to 6 months after dapagliflozin treatment (under stable antiproteinuric treatment), Change in glomerular filtration rate (in ml/min/1.73m2) from baseline to 6 months after dapagliflozin treatment (under stable antiproteinuric treatment), Need for Rituximab treatment for clinical relapse (according to KDIGO 2021 guidelines and French 2022 guidelines), Change in cytokine profile from baseline to 6 months after dapagliflozin treatment (analysis of 9 cytokines: IL-12p70; IL-17A; IL-4; IL-5; IL-1β; IL-10; IFNα; IL-6 and IFNγ), Clinical and biological tolerance of dapagliflozin treatment

Source: https://euclinicaltrials.eu/ctis-public/view/2023-507658-34-00